EU clinical trial 2024-512717-41-00: An Open-Label, Phase 2 Trial of Nanatinostat in Combination with Valganciclovir in Patients with Epstein-Barr Virus-Positive (EBV+) Relapsed/Refractory Lymphomas (NAVAL-1)
Protocol code: VT3996-202
Sponsor: Viracta Therapeutics Inc. (Pharmaceutical company). Phase: Therapeutic exploratory (Phase II). Countries: Spain (ended), Germany (ended), Italy (ended), France (ended).
Therapeutic area(s): Diseases [C] - Neoplasms [C04]
Gender: Female, Male. Age: 0-17 years, 18-64 years, 65+ years. Enrolment: 84.
Status: Ended. Start date (EU): 2021-10-01. End date (EU): 2024-12-26. End date: 2025-02-11. Decision date: 2024-06-25. Results received: No. Last updated: 2024-09-05.
Decision dates by country: FR: 2024-06-27, DE: 2024-06-27, IT: 2024-09-05, ES: 2024-06-25

Condition(s): Epstein-Barr Virus-Positive (EBV+) Relapsed/Refractory Lymphomas
Product: Nanatinostat, VALGANCICLOVIR, GANCICLOVIR

Primary endpoint: Objective response rate (ORR) as assessed by an Independent Review Committee (IRC) per the 2007 International Working Group (IWG) criteria.
Endpoint(s): 1. Duration of response (DOR), 2. Time to next anti-lymphoma treatment, 3. Progression-free survival, 4. Time to progression, 5. Overall survival (OS), 6. Pharmacokinetic (PK) parameters (eg, time to maximum plasma concentration [tmax], maximum plasma concentration [Cmax], area under the plasma concentration-time curve [AUC]).

Source: https://euclinicaltrials.eu/ctis-public/view/2024-512717-41-00